EU clinical trial 2024-516616-24-00: A Phase 3 randomized 3-arm trial (double-blind Debio 4126, placebo control, and open-label Debio 4126), to assess the efficacy and safety of Debio 4126, a 12-week octreotide formulation, in patients with acromegaly previously treated with somatostatin analogs.
Protocol code: Debio 4126-301
Sponsor: Debiopharm International S.A. (Pharmaceutical company). Phase: Therapeutic confirmatory (Phase III). Countries: Romania (ongoing, recruiting), Spain (ongoing, recruiting), Austria (ongoing, recruiting), Italy (ongoing, recruiting), Estonia (authorised, recruiting), Lithuania (ongoing, recruiting), Denmark (ongoing, recruiting), Latvia (ongoing, recruiting), Germany (ongoing, recruiting), France (ongoing, recruiting), Poland (ongoing, recruiting), Sweden (ongoing, recruiting), Hungary (ongoing, recruiting), Belgium (authorised, recruiting), Slovakia (ongoing, recruiting), Bulgaria (ongoing, recruiting).
Therapeutic area(s): Diseases [C] - Hormonal diseases [C19]
Gender: Female, Male. Age: 18-64 years, 65+ years. Enrolment: 100.
Start date (EU): 2025-07-23. Decision date: 2025-06-30. Results received: No. Last updated: 2026-07-28.
Decision dates by country: RO: 2025-07-07, SK: 2025-06-30, PL: 2025-07-07, EE: 2025-07-02, DE: 2025-07-02, BE: 2025-06-30, AT: 2025-07-07, BG: 2025-07-04, SE: 2025-07-04, HU: 2025-07-02, FR: 2025-07-03, LT: 2025-07-02, IT: 2025-07-01, DK: 2025-06-30, LV: 2025-07-01, ES: 2025-07-07

Condition(s): Acromegaly
Product: OCTREOTIDE, LANREOTIDE, Debio 4126, Ready-to-use suspension resembling 30, 60, or 90 mg Debio 4126 doses, Debio 4126, LANREOTIDE, OCTREOTIDE, OCTREOTIDE, Debio 4126, LANREOTIDE

Primary endpoint: Percentage of participants with IGF-1 ≤1x ULN at W36, where IGF-1 will be based on the average of 2 samples acquired at W34 and W36. If this average IGF-1 is ≤1x ULN, a participant is classified as a responder
Endpoint(s): Percentage of Participants With IGF-1 ≤1x ULN at W36, in Arm C, Change From Baseline in IGF-1 Values, Percent Change From Baseline in IGF-1 Values, Percentage of Participants With IGF-1 ≤1x ULN, Percentage of Participants With GH Level <1 ng/mL, Change From Baseline in GH Values, Mean Logarithm With Base 10 (Log10) Change From Baseline in GH Values, Percentage of Participants With GH Value per Category (<1; ≥1 and <2.5; ≥2.5 (ng/mL), Number of Participants With at Least one Treatment-Emergent Adverse Event (TEAE), in Arms A and B, up to W36, Number of Participants With Clinically Significant Abnormalities in Laboratory Parameters, Vital Signs, Electrocardiogram (ECG), and Pituitary Tumor Size, in Arms A and B, up to W36, Number of Participants With at Least one TEAE in Arms A, B and C, Time-at-Risk Exposure-Adjusted Incidence Rate for TEAEs, Total Participant-Years at-Risk for TEAEs, Number of Participants With Clinically Significant Abnormalities in Laboratory Parameters, Vital Signs, ECG, and Pituitary Tumor Size in Arms A, B and C, Local Tolerability of Debio 4126 as Assessed by Erythema, Swelling, and Induration at the Injection Site Using Investigator Assessment, Local Tolerability of Debio 4126 as Assessed by Pain at Injection Site Based on Pain Visual Analog Scale (VAS) Score, Percentage of Participants Taking Rescue Medication, PK parameters of Debio 4126, including but not limited to octreotide concentration at the end of the 12-week Treatment Interval (Ctrough)

Source: https://euclinicaltrials.eu/ctis-public/view/2024-516616-24-00